EU clinical trial 2024-515832-59-00: An Open-label Extension Study of ARGX-113-2009 to Evaluate the Long-term Safety, Tolerability, and Efficacy of Efgartigimod PH20 SC in Adult Participants With Bullous Pemphigoid
Protocol code: ARGX-113-2010
Sponsor: Argenx (Pharmaceutical company). Phase: Therapeutic confirmatory (Phase III). Countries: Bulgaria (ended), Italy (ended), Czechia (ended), Spain (ended), Hungary (ended), Slovakia (ended), Netherlands (ended), Germany (ended), Croatia (ended), Greece (ended).
Therapeutic area(s): Diseases [C] - Immune System Diseases [C20]
Gender: Female, Male. Age: 18-64 years, 65+ years. Enrolment: 43.
Status: Ended. Start date (EU): 2022-05-03. End date (EU): 2025-01-13. End date: 2025-03-20. Decision date: 2024-10-24. Results received: Yes. Last updated: 2025-01-23.
Decision dates by country: HR: 2024-12-03, BG: 2024-10-25, DE: 2024-10-24, CZ: 2024-10-24, HU: 2024-10-25, SK: 2024-10-25, GR: 2024-10-24, NL: 2024-10-24, IT: 2024-12-04, ES: 2024-10-24

Condition(s): Bullous Pemphigoid
Product: PBO PH20 SC, ARGX-113

Primary endpoint: • Incidence and severity of treatment-emergent AEs, SAEs, and AESIs, • Rate of treatment discontinuation because of safety concerns
Endpoint(s): Proportions of participants achieving: − CR while off OCS for ≥8 weeks − CR or PR while off OCS for ≥8 weeks − CR while on minimal OCS therapy for ≥8 weeks. (Minimal OCS therapy is defined as ≤0.10 mg/kg/day of prednisone [or an equivalent dose of another OCS]) − CR while off both OCS and efgartigimod PH20 SC for ≥8 weeks − CR or PR while off both OCS and efgartigimod PH20 SC for ≥8 weeks, • Proportions of participants achieving: − CR while off OCS for ≥8 weeks − CR or PR while off OCS for ≥8 weeks − CR while on minimal OCS therapy for ≥8 weeks. (Minimal OCS therapy is defined as ≤0.10 mg/kg/day of prednisone [or an equivalent dose of another OCS]) − CR while off both OCS and efgartigimod PH20 SC for ≥8 weeksb − CR or PR while off both OCS and efgartigimod PH20 SC for ≥8 weeksb, Duration of sustained remission, Proportion of participants who relapse, Time to relapse, Incidence and severity of relapse, BPDAI activity scores, IGA-BP scores, and itch NRS over time, Rate of treatment failure, GTI-related scores, including the GTI-AIS, GTI-CWS, and GTI-SL over time, EQ-5D-5L, DLQI, and ABQoL scores over time, Percent change from baseline over time for anti-BP180 and anti-BP230 antibody levels, Incidence and prevalence of ADA

Source: https://euclinicaltrials.eu/ctis-public/view/2024-515832-59-00